EU clinical trial 2025-522038-29-00: A Phase 3, Randomized, Double-blind, Placebo- and Active-Comparator-Controlled Study of MK-1084 Plus Durvalumab Versus Placebo Plus Durvalumab in Participants With Locally Advanced, Unresected KRAS G12C-Mutant Non-Small Cell Lung Cancer Without Disease Progression Following Definitive Platinum-Based Chemoradiotherapy (KANDLELIT-015)
Protocol code: MK-1084-015
Sponsor: Merck Sharp & Dohme LLC (Pharmaceutical company). Phase: Therapeutic confirmatory (Phase III). Countries: Italy (authorised, recruiting), Netherlands (authorised, recruiting), France (authorised, recruitment pending), Germany (authorised, recruiting), Spain (ongoing, recruiting), Poland (authorised, recruitment pending), Greece (ongoing, recruiting).
Therapeutic area(s): Diseases [C] - Neoplasms [C04]
Gender: Female, Male. Age: 18-64 years, 65+ years. Enrolment: 88.
Start date (EU): 2026-06-16. Decision date: 2026-06-12. Results received: No. Last updated: 2026-06-22.
Decision dates by country: FR: 2026-06-12, DE: 2026-06-16, GR: 2026-06-16, IT: 2026-06-12, ES: 2026-06-22, NL: 2026-06-15, PL: 2026-06-18

Condition(s): Locally advanced, unresected (unresectable or medically inoperable or refuse surgery) Stage II-III NSCLC with KRAS G12C mutation
Product: MK-1084, DURVALUMAB, MK-1084, Placebo for MK-1084

Primary endpoint: Progression-Free Survival (PFS)
Endpoint(s): Overall Survival (OS), Number of Participants Who Experience an Adverse Event (AE), Number of Participants Who Discontinue Study Treatment Due to an AE, Objective Response Rate (ORR), Duration of Response (DOR), Distant Metastasis-Free Survival (DMFS), Change From Baseline in European Organization for Research and Treatment of Cancer Quality of Life Questionnaire-Core 30 (EORTC QLQ-C30) Global Health Status (GHS)/Quality of Life (QoL) (Items 29 & 30) Combined Score, Change From Baseline in Physical Functioning (EORTC QLQ-C30 Items 1-5) Combined Score, Change from Baseline in Role Functioning (EORTC QLQ-C30 Items 6 & 7) Combined Score

Source: https://euclinicaltrials.eu/ctis-public/view/2025-522038-29-00